EU clinical trial 2024-517599-39-00: Impact of continuous oxygen flow with or without airway pressure in the non-dependent lung during one-lung ventilation on postoperative complications in lung resection surgery: A randomized controlled clinical trial
Protocol code: ECAOI-22
Sponsor: Hospital General Universitario Gregorio Maranon (Hospital/Clinic/Other health care facility). Phase: Therapeutic use (Phase IV). Countries: Spain (ongoing, recruiting).
Therapeutic area(s): Diseases [C] - Neoplasms [C04]; Diseases [C] - Respiratory Tract Diseases [C08]
Gender: Female, Male. Age: 18-64 years, 65+ years. Enrolment: 177.
Status: Ongoing, recruiting. Start date (EU): 2025-01-27. Decision date: 2025-01-23. Results received: No. Last updated: 2025-07-04.

Condition(s): Lung Resection Surgery
Product: Oxígeno Medicinal Gas Nippon Gases 200 bar, gas comprimido medicinal en bala de gas.

Primary endpoint: To compare the appearance of postoperatory complication according to the Clavien-Dindo scale.
Endpoint(s): The following aspects will be compared among the three groups: gas exchange and acid-base balance during intra and postoperative periods, degree of interference with surgical exposure, incidence of postoperative pulmonary complications, length of stay in special care units, need for readmission to those units, duration of hospital stay, hospital readmission, comparison of inflammatory biomarkers in blood and bronchoalveolar lavage, identification of new molecules involved in oxidative stress.

Source: https://euclinicaltrials.eu/ctis-public/view/2024-517599-39-00